EU clinical trial 2022-502519-13-00: A Multicenter, Randomized, Double-Blind Placebo-Controlled Phase 3 Study to Evaluate the Pharmacokinetics, Efficacy and Safety of Deucravacitinib (BMS-986165) in Pediatric Subjects with Moderate to Severe Plaque Psoriasis
Protocol code: IM011-126
Sponsor: Bristol-Myers Squibb Services Unlimited Company (Pharmaceutical company). Phase: Therapeutic confirmatory (Phase III). Countries: France (ongoing, recruiting), Spain (ongoing, recruiting), Poland (ongoing, recruiting), Germany (ongoing, recruiting), Romania (ongoing, recruiting).
Therapeutic area(s): Diseases [C] - Immune System Diseases [C20]
Gender: Female, Male. Age: 0-17 years. Enrolment: 84.
Status: Ongoing, recruiting. Start date (EU): 2021-05-07. Decision date: 2023-06-19. Results received: No. Last updated: 2026-03-23.
Decision dates by country: PL: 2023-07-04, DE: 2024-07-05, FR: 2023-07-17, ES: 2023-06-19, RO: 2024-06-17

Condition(s): Moderate to Severe Plaque Psoriasis
Product: deucravacitinib 6 mg tablet, deucravacitinib, Deucravacitinib 2 mg sachet, Deucravacitinib 3 mg sachet, Deucravacitinib 1 mg sachet, deucravacitinib, deucravacitinib, deucravacitinib

Primary endpoint: PART A: Geometric mean observed average concentration at steady state (Cavg.ss), maximum observed plasma concentration at steady state (Cmax), and trough observed plasma concentration (Ctrough) for deucravacitinib., PART B: 1. Proportion of subjects with at least 75% improvement in Psoriasis Area and Severity Index (PASI 75), PART B: 2. Proportion of subjects with an sPGA score of 0 (clear) or 1 (almost clear) with at least a 2-point reduction from baseline, LTE Period: 1. AEs and SAEs, LTE Period: 2. Monitoring of growth including body weight and height and sexual maturation

Source: https://euclinicaltrials.eu/ctis-public/view/2022-502519-13-00